EU clinical trial 2025-523850-15-00: Exogenous progesterone as ovulation trigger – a pilot study
Protocol code: 2504-LIS-054-AN
Sponsor: Instituto Valenciano De Infertilidade Clinica De Reproducao Assistida Lda. (Hospital/Clinic/Other health care facility). Phase: Therapeutic use (Phase IV). Countries: Portugal (authorised, recruitment pending).
Therapeutic area(s): Diseases [C] - Female Urogenital Diseases and Pregnancy Complications [C13]
Gender: Female. Age: 18-64 years. Enrolment: 10.
Status: Authorised, recruitment pending. Decision date: 2026-05-22. Results received: No. Last updated: 2026-05-22.

Condition(s): Infertility
Product: Cyclogest 400 mg óvulos

Primary endpoint: Number of mature oocytes (MII) following progesterone-induced oocyte maturation.
Endpoint(s): Endocrinological profile (E2, P4, LH and FSH) 12h after trigger, Endocrinological profile (E2, P4, LH and FSH) on the morning of egg retrieval

Source: https://euclinicaltrials.eu/ctis-public/view/2025-523850-15-00